EU clinical trial 2022-503093-36-00: Phase I trial of CArbonic Anhydrase Inhibition in combination with radiochemotherapy or radioimmunotherapy in small cell lung carcinoma (ICAR)
Protocol code: ICAR
Sponsor: Centre Antoine Lacassagne (Health care). Phase: Human Pharmacology (Phase I)- Other. Countries: France (temporarily halted).
Therapeutic area(s): Diseases [C] - Neoplasms [C04]
Gender: Female, Male. Age: 18-64 years, 65+ years. Enrolment: 27.
Status: Temporarily halted. Start date (EU): 2020-01-27. Decision date: 2023-02-09. Results received: No. Last updated: 2025-08-29.

Condition(s): lung carcinoma
Product: Diamox 250 mg Comprimés

Primary endpoint: The primary endpoint will be based on the frequencies of dose-limiting toxicities determined during : - 6-7 weeks of acetazolamide/radiochemotherapy with platinum salts and etoposide and within the first 6 months after the last administration of radiochemotherapy, for the subgroup "localised CPC"; - The 10 days of acetazolamide/radio-immunotherapy treatment and within the first 6 months after the last administration of radio-immunotherapy, for the subgroup "extensive CPC".
Endpoint(s): The overall safety of acetazolamide in combination with radiochemotherapy throughout the duration of patient participation will be assessed by clinical, biological and paraclinical means (plethysmography) and rated according to the NCI CTCAE V4.03 scale, The overall safety of acetazolamide in combination with radioimmunotherapy throughout the duration of patient participation will be assessed by clinical, biological and paraclinical means (plethysmography) and rated according to the NCI CTCAE V4.03 scale, Tumour response (complete or partial, stabilisation, progression) will be assessed by morphological (RECIST 1.1) and metabolic (PERCIST 1.0) evaluations, Evaluation of predictive factors for response to acetazolamide will be determined by serum CAIX and CAXII levels, and 18-FDG PET scan binding intensity (SUVmax; SULpeak), Progression-free survival at 24 months will be assessed by calculating the time from the date of inclusion to the date of progression or death from any cause., Overall survival at 24 months will be assessed by calculating the time from the date of inclusion to the date of death from all causes, Compliance will be assessed using the Girerd questionnaire, Quality of life will be assessed using the EORTC QLQ-C30 questionnaire

Source: https://euclinicaltrials.eu/ctis-public/view/2022-503093-36-00